EU clinical trial 2023-503938-52-00: Clinical and translational controlled study of Perampanel treatment around Surgery in patients with progressive glioblastoma (PerSurge)
Protocol code: PerSurge
Sponsor: Universitaetsklinikum Heidelberg AöR (Hospital/Clinic/Other health care facility). Phase: Therapeutic exploratory (Phase II). Countries: Germany (ongoing, recruiting).
Therapeutic area(s): Diseases [C] - Neoplasms [C04]
Gender: Female, Male. Age: 18-64 years, 65+ years. Enrolment: 66.
Status: Ongoing, recruiting. Start date (EU): 2024-01-26. Decision date: 2023-11-30. Results received: No. Last updated: 2024-09-20.

Condition(s): Progressive Glioblastoma
Product: Füllstoff DAC in hard gelatine capsules is used as placebo. Füllstoff DAC consists of mannitol 99.5 % and colloidal Silicon Dioxide 0.5 %., Fycompa 2 mg film-coated tablets

Primary endpoint: A) Connectivity score determined in RNA Seq from tumour tissue (tumour cryosamples), B) Kinetics in T2/FLAIR signal abnormality volume by central AI-based MRI assessment per BIRC [from baseline to pre-surgical resection]
Endpoint(s): pre-surgical and post-surgical log-transformed tumour volume [cm³] per the BIRC based on AIquantified MRI parameters (T1CE images) [day 0 to day 30 prior to surgery; post-surgical: POD0 to POD30], post-surgical log-transformed tumour volume [cm³] per the BIRC based on AI-quantified MRI parameters, incorporating the volumes from peri-tumoral T2/FLAIR signal abnormality, excluding those areas showing ischemia (based on DWI) [on immediate postoperative MRI to day 60 post-randomisation, i.e. POD0-3 to POD30], EORTC QLQ-C30, QLQ-BN20: absolute change from baseline at POD30 in the C30 summary score (according to EORTC manual; with higher scores indicating worse symptoms), MMSE: absolute change from baseline at POD30 in total MMSE score., OS defined as the time from the date of randomisation to the date of death due to any cause., imaging-based PFS defined as time from date of randomisation to date of first documented radiographic progression (according to the RANO criteria37,38 and Appendix A2) which include observer-blinded MRI-based assessments and clinical stability) or date of death due to any cause, whichever occurs first., total number of epileptic seizures (irrespective of severity and duration) between baseline and POD30, occurrence of side effects (AE, SAE, SUSARs) until 3 days after end of treatment (adverse events will be coded using MedDRA).

Source: https://euclinicaltrials.eu/ctis-public/view/2023-503938-52-00